EU clinical trial 2024-511021-58-00: First-line Tarlatamab in Combination With Carboplatin, Etoposide, and PD-L1 Inhibitor in Subjects with Extensive Stage Small Cell Lung Cancer (ES SCLC) (DeLLphi-303)
Protocol code: 20200469
Sponsor: Amgen Inc. (Pharmaceutical company). Phase: Human Pharmacology (Phase I)- Other. Countries: Germany (ongoing, recruitment ended), Netherlands (ongoing, recruitment ended), France (ongoing, recruitment ended), Belgium (ongoing, recruitment ended), Spain (ongoing, recruitment ended), Italy (ongoing, recruitment ended).
Therapeutic area(s): Diseases [C] - Neoplasms [C04]
Gender: Female, Male. Age: 18-64 years, 65+ years. Enrolment: 80.
Status: Ongoing, recruitment ended. Start date (EU): 2022-08-02. Decision date: 2024-08-23. Results received: No. Last updated: 2026-07-07.
Decision dates by country: DE: 2024-08-26, NL: 2024-08-26, FR: 2024-08-28, IT: 2024-09-30, ES: 2024-08-23, BE: 2024-08-26

Condition(s): Extensive Stage Small cell lung cancer (ES-SCLC)

Source: https://euclinicaltrials.eu/ctis-public/view/2024-511021-58-00